EU clinical trial 2025-521546-23-00: A randomized, double-blind, placebo-controlled Phase III study to evaluate the efficacy and safety of remibrutinib in patients with secondary progressive multiple sclerosis
Protocol code: CLOU064P12301
Sponsor: Novartis Pharma AG (Pharmaceutical company). Phase: Therapeutic confirmatory (Phase III). Countries: Denmark (ongoing, recruiting), Slovenia (authorised, recruitment pending), Netherlands (ongoing, recruiting), Portugal (ongoing, recruiting), Ireland (authorised, recruitment pending), Sweden (authorised, recruitment pending), Croatia (ongoing, recruiting), Greece (authorised, recruitment pending), Germany (ongoing, recruiting), Latvia (authorised, recruitment pending), Czechia (ongoing, recruiting), Spain (ongoing, recruiting), Romania (ongoing, recruiting), Belgium (authorised, recruitment pending), Austria (ongoing, recruiting), Lithuania (ongoing, recruiting), Slovakia (ongoing, recruiting), Poland (ongoing, recruiting), Estonia (ongoing, recruiting), Bulgaria (ongoing, recruiting), France (ongoing, recruiting), Italy (ongoing, recruiting), Hungary (ongoing, recruiting), Finland (authorised, recruitment pending), Norway (authorised, recruitment pending).
Therapeutic area(s): Diseases [C] - Nervous System Diseases [C10]
Gender: Female, Male. Age: 18-64 years, 65+ years. Enrolment: 677.
Start date (EU): 2026-04-21. Decision date: 2026-03-03. Results received: No. Last updated: 2026-07-30.
Decision dates by country: AT: 2026-03-09, BG: 2026-03-05, RO: 2026-03-09, EE: 2026-03-09, LV: 2026-03-04, SE: 2026-03-03, BE: 2026-03-03, PT: 2026-03-06, DE: 2026-03-04, SK: 2026-03-03, NL: 2026-03-03, PL: 2026-03-07, IT: 2026-03-04, GR: 2026-03-06, HU: 2026-03-09, FR: 2026-03-05, ES: 2026-03-04, DK: 2026-03-03, HR: 2026-03-06, IE: 2026-03-06, LT: 2026-03-04, SI: 2026-03-04, NO: 2026-07-01, FI: 2026-06-25, CZ: 2026-03-04

Condition(s): Secondary progressive multiple sclerosis
Product: Placebo to Remibrutinib (LOU064) film-coated tablets, LOU064

Primary endpoint: Time to 6-month confirmed disability progression (6mCDP) on Expanded Disability Status Scale (EDSS)
Endpoint(s): Time to 3-month confirmed disability progression (3mCDP) on EDSS (key secondary), Time to 6-month confirmed disability improvement (6mCDI) on EDSS (key secondary), Time to 3-month worsening by at least 20% in Timed 25-Foot Walk (T25FW) (key secondary), Time to 3-month worsening by at least 20% in 9-Hole Peg Test (9-HPT) (key secondary), Annualized rate of new or enlarging T2 lesions (key secondary), Percentage of participants with annualized rate of brain atrophy > XX (key secondary), Time to 6-month worsening by at least 4 points in Symbol Digit Modalities Test (SDMT), Adverse events, laboratory data, vital signs, electrocardiogram (ECG), Columbia Suicide Severity Rating Scale (C-SSRS)

Source: https://euclinicaltrials.eu/ctis-public/view/2025-521546-23-00